EU clinical trial 2024-513356-15-00: A Randomised, Double-Masked, Placebo-Controlled Phase 3 Study on the Efficacy and Safety of STN1013800 (Oxymetazoline HCl 0.1% Eye Drops) used twice daily (BID) in the Treatment of Acquired Blepharoptosis
Protocol code: 101380003SA
Sponsor: Santen (Pharmaceutical company). Phase: Therapeutic confirmatory (Phase III). Countries: Hungary (ongoing, recruiting), Germany (ended), Spain (ongoing, recruiting), Italy (ongoing, recruiting), France (ongoing, recruiting), Czechia (ongoing, recruiting), Netherlands (ongoing, recruiting), Poland (ongoing, recruiting), Bulgaria (ongoing, recruiting), Romania (authorised, recruiting).
Therapeutic area(s): Diseases [C] - Eye Diseases [C11]
Gender: Female, Male. Age: 18-64 years, 65+ years. Enrolment: 343.
Start date (EU): 2024-12-30. Decision date: 2024-11-20. Results received: No. Last updated: 2026-07-27.
Decision dates by country: DE: 2024-11-20, CZ: 2024-11-21, HU: 2024-11-20, PL: 2024-11-24, FR: 2025-01-21, ES: 2024-11-22, IT: 2024-11-21, NL: 2024-11-25, BG: 2026-07-02, RO: 2026-07-27

Condition(s): Acquired Blepharoptosis
Product: Placebo to OXYMETAZOLINE HYDROCHLORIDE (Vehicle), STN1013800

Primary endpoint: Change from baseline in MRD1 on Day 14
Endpoint(s): PRO: PGIC on Day 14

Source: https://euclinicaltrials.eu/ctis-public/view/2024-513356-15-00